EU clinical trial 2024-512742-42-00: Exploratory clinical trial to assess safety, tolerability efficacy and pharmacokinetics of CEB-01 PLGA membrane in participants with pancreatic cancer
Protocol code: CEB-01-RLPC01-CT
Sponsor: Cebiotex S.L. (Pharmaceutical company). Phase: Therapeutic exploratory (Phase II). Countries: Spain (ongoing, recruiting).
Therapeutic area(s): Diseases [C] - Neoplasms [C04]
Gender: Female, Male. Age: 18-64 years, 65+ years. Enrolment: 39.
Status: Ongoing, recruiting. Start date (EU): 2024-08-09. Decision date: 2024-06-28. Results received: No. Last updated: 2026-03-06.
Decision dates by country: ES: 2024-09-27

Condition(s): Pancreatic carcinoma

Primary endpoint: Serious and non-serious Adverse Events (AE) according to the most updated version of the Common Terminology Criteria for Adverse Events (CTCAE)., International Patient Safety Goals (IPSG) after pancreatic surgery.
Endpoint(s): Local recurrence-free survival (LRFS)., Progression-free survival (PFS)., Overall survival (OS)., Pharmacokinetic analysis of multiple plasma samples obtained before and after the implant of CEB-01 to calculate: Area under the concentration-time curve (AUC0-inf), Maximum concentration (Cmax), Time of maximum plasma concentration (Tmax) and Terminal half-life (t1/2) of the active substance SN-38.

Source: https://euclinicaltrials.eu/ctis-public/view/2024-512742-42-00